EU clinical trial 2023-505065-91-00: A Phase 2, Open-Label, Parallel Cohort Study of Subcutaneous Amivantamab in Multiple Regimens in Patients with Advanced or Metastatic Solid Tumors including EGFR-mutated Non-Small Cell Lung Cancer
Protocol code: 61186372NSC2002
Sponsor: Janssen - Cilag International (Pharmaceutical company). Phase: Therapeutic exploratory (Phase II). Countries: Spain (ongoing, recruiting), Italy (ongoing, recruiting), France (ongoing, recruiting), Germany (ongoing, recruiting).
Therapeutic area(s): Diseases [C] - Neoplasms [C04]
Gender: Female, Male. Age: 18-64 years, 65+ years. Enrolment: 98.
Status: Ongoing, recruiting. Start date (EU): 2023-01-30. Decision date: 2024-04-17. Results received: No. Last updated: 2026-06-30.
Decision dates by country: ES: 2024-04-17, IT: 2024-04-17, FR: 2024-04-22, DE: 2024-04-19

Condition(s): Advanced or Metastatic Solid Tumors including EGFR-mutated Non-Small Cell Lung Cancer.
Product: CARBOPLATIN, PEMETREXED, JNJ-61186372, JNJ-73841937

Primary endpoint: ORR (INV)

Source: https://euclinicaltrials.eu/ctis-public/view/2023-505065-91-00